EU clinical trial 2024-519225-38-00: STOP-RIO: A randomized controlled non-inferiority trial to test the safety of discontinuation of riociguat after balloon pulmonary angioplasty in Chronic Thrombo-embolic Pulmonary Hypertension
Protocol code: 2024-519225-38-00
Sponsor: Amsterdam UMC Stichting (Patient organisation/association). Phase: Phase III and phase IV (Integrated). Countries: Netherlands (ongoing, recruiting).
Therapeutic area(s): Diseases [C] - Cardiovascular Diseases [C14]
Gender: Female, Male. Age: 18-64 years, 65+ years. Enrolment: 74.
Status: Ongoing, recruiting. Start date (EU): 2025-10-28. Decision date: 2025-09-29. Results received: No. Last updated: 2025-09-29.

Condition(s): Chronic thromboembolic pulmonary hypertension (CTEPH)
Product: Adempas 2.5 mg film-coated tablets

Primary endpoint: Difference in mPAP between the riociguat discontinuation group and continuation group at the end of study follow-up (16 weeks)
Endpoint(s): Efficacy endpoints: Differences between the intervention (discontinuation of riociguat) and control group (continuation of riociguat) at the end of the study follow-up for the following parameters in hierarchical order: NT-proBNP, 6MWD, PVR, Cardiac index, Post hoc analysis of group differences in exercise capacity at the end of study follow-up (16 weeks): CPET variables (peak VO₂, load max, HR max, RER max, VE max, SpO₂ rest/max, O₂ pulse max, EqCO₂ at AT/max) and change in modified Borg dyspnoea scale, Safety endpoints: group differences at end of study follow-up (16 weeks) in number of AEs and SAEs, proportion of patients with mPAP ≥38 mmHg at RHC, and proportion meeting clinical worsening criteria at week 8, Feasibility of the strategy: 1) Is TTE sufficient to replace RHC at end of study follow-up (16 weeks)? Assessed via correlation between TTE and RHC (RVSP, TAPSE) and proportion of subjects with mPAP ≥38 mmHg missed by TTE at the end of study follow-up. 2) Is the discontinuation strategy feasible in practice? Assessed via subjects missed by clinical worsening criteria with mPAP >38mmHg at end of study follow-up, and subject satisfaction with the protocol., Economic outcomes: difference in costs related to PH therapy and overall healthcare consumption, including frequency of visits to expert centers vs. local hospitals, travel distance for medical care, and number of emergency department visits., Patient-related outcomes: differences between discontinuation and continuation groups at end of study follow-up in WHO functional class and QoL scores (LPHQ, EQ-5D-5L). Also, number of predefined graded AEs including hypotension, dizziness, and diarrhoea.

Source: https://euclinicaltrials.eu/ctis-public/view/2024-519225-38-00